EU clinical trial 2024-516083-28-00: 99mTc-MIP-1404 SPECT/CT for primary PROstate cancer STAging: comparative prospective, randomized trial to present guideline imaging, PROSTAMIP
Sponsor: Turku University Hospital (Hospital/Clinic/Other health care facility). Phase: Phase II and Phase III (Integrated). Countries: Finland (ongoing, recruiting).
Therapeutic area(s): Diseases [C] - Male Urogenital Diseases [C12]; Analytical, Diagnostic and Therapeutic Techniques and Equipment [E] - Diagnosis [E01]
Gender: Male. Age: 18-64 years, 65+ years. Enrolment: 320.
Status: Ongoing, recruiting. Start date (EU): 2022-06-01. Decision date: 2024-12-20. Results received: No. Last updated: 2024-12-20.

Condition(s): Prostate cancer
Product: 18F-PSMA-1007, Pylclari 1 000 MBq/mL solution for injection, 99mTc-MIP-1404

Primary endpoint: The proportion of subjects with local lymph node metastasi(e)s in control and experimental arms reported by ce-wbCT reader 1 and 99Tc-MIP-1404 SPECT/CT reader 1 respectively
Endpoint(s): The proportion of metastatic (local lymph node and/ or distant metastasis) subjects in control (a combination of 99mTc-HMDP planar BS and ce-wbCT) and experimental arms (99mTc-MIP-1404 SPECT/CT), The proportion of subjects with bone metastasis in control (a combination of 99mTc- HMDP planar BS and ce-wbCT) and in experimental arm (99mTc-MIP-1404 SPECT/CT), Sensitivity, specificity, accuracy, and AUC of 99mTc-MIP-1404 SPECT/CT, 18F-PSMA- 1007 PET/CT, 18F-DCFPyl-PSMA PET/CT, and bi-parametric prostate MRI detecting local tumor in prostate, extracapsular extension and seminal vesicle invasion in intervention arm, Sensitivity, specificity, accuracy, and AUC of ce-wbCT, 99mTc-MIP-1404 SPECT/CT, 18FPSMA- 1007 PET/CT, 18F-DCFPyl-PSMA PET/CT, and bi-parametric prostate MRI detecting subjects with local lymph node metastasis in intervention arm, Sensitivity, specificity, accuracy, and AUC of a combination of 99mTc-HMDP planar BS and ce-wbCT, 99mTc-MIP-1404 SPECT/CT, 18F-PSMA-1007 PET/CT, and 18F-DCFPyl- PSMA PET/CT detecting subjects with bone metastasis in intervention arm, The number of true positive, false positive, and false negative lesions in a combination of 99mTc-HMDP planar BS and ce-wbCT, 99mTc-MIP-1404 SPECT/CT, 18FPSMA- 1007 PET/CT, and 18F-DCFPyl-PSMA PET/CT in intervention arm, Cohen’s Kappa between the two readers in each modality, The number and proportion of subjects in which treatment recommendation was changed due to 99mTc-MIP 1404 SPECT/CT or 18F-PSMA-1007 PET/CT

Source: https://euclinicaltrials.eu/ctis-public/view/2024-516083-28-00